EU clinical trial 2024-512969-14-01: Fecal Microbiota Transplantation in the prevention of complications after allogeneic hematopoietic stem cell transplantation for hematologic malignancy
Protocol code: PHRC N 2018 BAY
Sponsor: CHU Gabriel-Montpied (Hospital/Clinic/Other health care facility). Phase: Therapeutic exploratory (Phase II). Countries: France (ongoing, recruiting).
Therapeutic area(s): Diseases [C] - Hemic and Lymphatic Diseases [C15]
Gender: Female, Male. Age: 18-64 years, 65+ years. Enrolment: 165.
Status: Ongoing, recruiting. Start date (EU): 2022-05-02. Decision date: 2024-11-18. Results received: No. Last updated: 2026-06-05.

Condition(s): Patient who underwent Allogeneic hematopoietic stem cell transplantation (allo-HSCT) for various haematological malignancies
Product: Transplant microbiote fécal

Primary endpoint: GRFS (Graft-versus-host disease and Relapse-Free Survival) rate at 1 year post-allograft.
Endpoint(s): Survival at 1 and 2 years (overall and progression-free), Evaluation of hematological criteria, Assessment of GVHD, Incidence of infectious complications, Tolerance and safety of post-allo-HSCT FMT, Evolution of the composition and diversity of the microbiota, Quality of life

Source: https://euclinicaltrials.eu/ctis-public/view/2024-512969-14-01